EU clinical trial 2023-505061-82-01: A Phase 3 Randomized, Placebo-Controlled, Double-Blind Program to Evaluate Efficacy and Safety of Upadacitinib in Adult and Adolescent Subjects with Severe Alopecia Areata
Protocol code: M23-716
Sponsor: AbbVie Deutschland GmbH & Co. KG (Pharmaceutical company). Phase: Therapeutic confirmatory (Phase III). Countries: Germany (ongoing, recruitment ended), Belgium (ongoing, recruitment ended), Poland (ongoing, recruitment ended), Italy (ongoing, recruitment ended), Portugal (ongoing, recruitment ended), Croatia (ongoing, recruitment ended), Bulgaria (ongoing, recruitment ended), Sweden (ongoing, recruitment ended), Hungary (ongoing, recruitment ended), Slovakia (ongoing, recruitment ended), Greece (ongoing, recruitment ended), France (ongoing, recruitment ended), Spain (ongoing, recruitment ended).
Therapeutic area(s): Diseases [C] - Immune System Diseases [C20]
Gender: Female, Male. Age: 0-17 years, 18-64 years. Enrolment: 539.
Status: Ongoing, recruitment ended. Start date (EU): 2024-06-17. Decision date: 2024-03-18. Results received: No. Last updated: 2026-05-25.
Decision dates by country: HR: 2024-03-22, HU: 2024-06-17, SK: 2024-03-21, GR: 2024-03-22, ES: 2024-03-18, PL: 2024-03-25, SE: 2024-03-22, FR: 2024-03-20, PT: 2024-06-07, IT: 2024-03-22, BE: 2024-03-20, DE: 2024-03-20, BG: 2024-03-25

Condition(s): Alopecia Areata
Product: Upadacitinib Placebo, Upadacitinib, Upadacitinib

Primary endpoint: Study 1 and Study 2 The primary endpoint is the achievement of SALT score ≤ 20 at Week 24, defined as less than or equal to 20% scalp hair loss.
Endpoint(s): Achievement of SALT score <= 10 at Week 24, Achievement of SALT score <= 20 at Week 12, Achievement of ClinRO measure for Eyebrow Hair Loss of 0 or 1 at Week 24 with a ≥ 2-point improvement (reduction) from Baseline among subjects with Baseline score ≥ 2, Achievement of ClinRO measure for Eyelash Hair Loss of 0 or 1 at Week 24 with a ≥ 2-point improvement (reduction) from Baseline among subjects with Baseline score ≥ 2, Achievement of SALT 75 at Week 24, Achievement of SALT 90 (at least a 90% improvement [decrease] from Baseline in SALT score) at Week 24, Percent change from Baseline in SALT score at Week 24, Achievement of PaGIC-AA score of 1 "much better" or 2 "moderately better" at Week 24, Achievement of PRO for Scalp Hair Assessment 0/1 with ≥ 2-point improvement (reduction) from Baseline at Week 24 among subjects with Baseline score ≥ 3, Change from Baseline in Skindex-16 AA Emotions Domain scores at Week 24, Change from Baseline in Skindex-16 AA Functioning Domain scores at Week 24, Change from Baseline in AASIS Interference Subscale score at Week 24, Change from Baseline in AASIS Symptoms Subscale score at Week 24, ·Achievement of HADS-A < 8 and HADS-D < 8 at Week 24 among subjects with HADS-A ≥ 8 or HADS-D ≥ 8 at Baseline, Achievement of SALT score 0 at Week 24, Achievement of SALT score ≤ 20 at Week 8, Achievement of PaGIC-AA score of 1 "much better" or 2 "moderately better" at Week 4, Achievement of SALT score ≤ 20 at Week 4, Achievement of SALT score <= 20 at Week 24, for the comparison of upadacitinb 15 mg QD versus placebo

Source: https://euclinicaltrials.eu/ctis-public/view/2023-505061-82-01